EU clinical trial 2024-514685-39-00: A Pilot / Phase 2 Clinical Trial of GSL-01-001 Administered Orally for 12 Weeks Preceded by a 2 Week Screening Period in Patients Presenting with Symptoms Associated with Irritable Bowel Syndrome with code GSL-01-001
Protocol code: GSL-01-001
Sponsor: Cannabibs Sp. z o.o. (Pharmaceutical company). Phase: Therapeutic exploratory (Phase II). Countries: Poland (ongoing, recruiting).
Therapeutic area(s): Diseases [C] - Digestive System Diseases [C06]
Gender: Female, Male. Age: 18-64 years. Enrolment: 35.
Status: Ongoing, recruiting. Start date (EU): 2025-02-25. Decision date: 2024-09-30. Results received: No. Last updated: 2025-10-06.

Condition(s): Irritable Bowel Syndrome (IBS) type D
Product: Arvisol 150mg

Primary endpoint: Primary safety endpoints include the evaluation of AEs and SAEs (in case of SAE with deaths and relation to IMP)., Primary efficacy endpoints include change from Baseline in scores at each week of abdominal bloating, discomfort, pain, cramping and nausea as well as stool consistency response: the average BSFS score of all reported bowel movements on the specific day (daily average).
Endpoint(s): Change from Baseline in abdominal pain, diarrhea, stool consistency, abdominal discomfort, bloating and cramping, nausea, percent change in abdominal pain – all at their worst; 6/12 week responder from Baseline in abdominal pain (≥30% decrease and ≥2-point improvement), abdominal discomfort (≥2-point improvement), bloating (≥2-point improvement and increase of ≥1 CSBM/week); treatment satisfaction; adequate relief; change in diarrhea and QOL assessment at weeks 4, 8 and 12.

Source: https://euclinicaltrials.eu/ctis-public/view/2024-514685-39-00